EU clinical trial 2024-514672-41-00: The Impact of Inhaled Furosemide and Perorally Administered Levodropropizine on Dyspnea in Patients With Advanced Respiratory Diseases (INFURO)
Protocol code: INFURO_2023
Sponsor: Fakultni Nemocnice Hradec Kralove (Hospital/Clinic/Other health care facility). Phase: Therapeutic exploratory (Phase II). Countries: Czechia (ongoing, recruiting).
Therapeutic area(s): Diseases [C] - Respiratory Tract Diseases [C08]
Gender: Female, Male. Age: 18-64 years, 65+ years. Enrolment: 114.
Status: Ongoing, recruiting. Start date (EU): 2024-02-27. Decision date: 2024-08-01. Results received: No. Last updated: 2026-07-01.

Condition(s): dyspnea perception in patients with advanced lung disease
Product: Furosemid Kabi 20 mg/2 ml injekční roztok, LEVODROPROPIZINE, SODIUM CHLORIDE

Primary endpoint: Safety and tolerability of a single dose of inhaled furosemide assessed as the incidence and nature of all reported treatment-related adverse events.
Endpoint(s): The effect of examined substances to suppress dyspnoea will be evaluated by changing to a visually analog scale (VAS) and the Borg scale. Changes on both steps will be evaluated statistically at the level of 5% probability and it will be determined whether the changes have achieved minimum clinically relevant changes against the default values. As a minimum clinically relevant change is considered 1 point in the Brog scale and 10 mm in VAS.

Source: https://euclinicaltrials.eu/ctis-public/view/2024-514672-41-00